EU clinical trial 2025-523974-18-00: EVALUATING THE EFFICACY AND SAFETY OF MET097, A FULLY- BIASED ULTRA LONG-ACTING GLP-1RA IN PEOPLE WITH OVERWEIGHT OR OBESITY: A PHASE 3, MULTI-CENTER RANDOMIZED, CONTROLLED TRIAL (VESPER-4)
Protocol code: MET097-25-301
Sponsor: Metsera Inc. (Pharmaceutical company). Phase: Therapeutic confirmatory (Phase III). Countries: Germany (ongoing, recruitment ended), Hungary (ended), Slovakia (ongoing, recruitment ended), Poland (ongoing, recruitment ended), Spain (ongoing, recruitment ended), Czechia (ongoing, recruitment ended), Romania (ongoing, recruitment ended), Bulgaria (ongoing, recruitment ended).
Therapeutic area(s): Diseases [C] - Nutritional and Metabolic Diseases [C18]
Gender: Female, Male. Age: 18-64 years, 65+ years. Enrolment: 894.
Start date (EU): 2026-04-30. Decision date: 2026-04-02. Results received: No. Last updated: 2026-08-03.
Decision dates by country: HU: 2026-04-08, SK: 2026-04-08, PL: 2026-04-07, ES: 2026-04-13, BG: 2026-04-14, CZ: 2026-04-03, RO: 2026-04-09, DE: 2026-04-08

Condition(s): Obesity
Product: MET097 Injection, 5mg/mL, MET097 matching placebo

Primary endpoint: Percent change from baseline in body weight at Week 64
Endpoint(s): Change from baseline in body weight (kg) at Week 64, Occurrence at Week 64 of: • CCI % of reduction from baseline body weight • CCI% of reduction from baseline body weight • CCI % of reduction from baseline body weight • O CCI % of reduction from baseline body weight, Change from baseline at Week 64 in: • Fasting triglycerides (mg/dL) • O Non-high-density lipoprotein-cholesterol (non-HDL-C) (mg/dL), Change from baseline in SBP (mmHg) at Week 64, Change from baseline in Short Form 36 health survey (SF-36) physical function domain score at Week 64, Percent change from baseline in body weight at Week 84, Change from baseline in body weight (kg) at Week 84

Source: https://euclinicaltrials.eu/ctis-public/view/2025-523974-18-00